EU clinical trial 2023-506979-10-00: A phase I/II trial of peri- and postoperative treatment with histamine dihydrocloride and low-dose interleukin-2 in patients with primary resectable pancreatic cancer.
Sponsor: Vaestra Goetalandsregionen (Hospital/Clinic/Other health care facility). Phase: Phase I and Phase II (Integrated)- Other. Countries: Sweden (ongoing, recruiting).
Therapeutic area(s): Diseases [C] - Neoplasms [C04]
Gender: Female, Male. Age: 18-64 years, 65+ years. Enrolment: 50.
Status: Ongoing, recruiting. Start date (EU): 2025-09-02. Decision date: 2024-05-17. Results received: No. Last updated: 2024-05-17.

Condition(s): Pancreatic cancer
Product: PROLEUKIN® 18 x 106 IU Powder for solution for injection or infusion, Ceplene 0.5 mg/0.5 mL solution for injection

Primary endpoint: The safety and tolerability of the treatment will be evaluated by the assessment of all adverse events (AEs) occurring during treatment—both those considered treatment-related and unrelated. Adverse events will be collected from Cycle 1 Day 1 through the final study visit and will be graded for severity according to the NCI-CTCAE, version 5.0. Safety will also be evaluated by clinical laboratory tests, physica
Endpoint(s): Secondary Efficacy Variables: Progression-free survival and overall survival, Secondary Outcome Biomarker Variables: • NK cell subsets in blood, including immature (CD16-) and cytotoxic (CD16+) subsets, activation markers, natural cytotoxicity receptors including NKp30, NKp46 and NKG2D, killer-immunoglobulin receptors. • T cell subsets including CD4+/25 regulatory T cells and naive, central memory, effector memory and effector CD8+ T cells, continuation Secondary Outcome: Biomarker Variables: • Myeloid cell populations including granulocytes and monocytes, MDSC, dendritic cells, activation markers, PD-L1, PD-L2 and related immune biomarkers. • Serum CA 19-9 • Serum levels of cytokines, chemokines and other soluble mediators of inflammation • Amount of tumor-infiltrating lymphocytes (TILs) and tumor-infiltrating myeloid cells

Source: https://euclinicaltrials.eu/ctis-public/view/2023-506979-10-00